EU clinical trial 2025-521036-11-00: A multicenter, multinational, randomized, double-blind, placebo-controlled Phase 3, induction study to evaluate the efficacy and safety of duvakitug in participants with moderately to severely active Crohn’s Disease
Protocol code: EFC18326
Sponsor: Sanofi-Aventis Recherche & Developpement (Pharmaceutical company). Phase: Therapeutic confirmatory (Phase III). Countries: Slovakia (ongoing, recruiting), Netherlands (ongoing, recruiting), Poland (ongoing, recruiting), Greece (authorised, recruitment pending), Czechia (ongoing, recruiting), Italy (ongoing, recruiting), Bulgaria (ongoing, recruiting), Belgium (ongoing, recruiting), Germany (ongoing, recruiting), Lithuania (ongoing, recruiting), Austria (ongoing, recruiting), Spain (ongoing, recruiting), Hungary (ongoing, recruiting), Norway (authorised, recruitment pending), France (ongoing, recruiting).
Therapeutic area(s): Diseases [C] - Immune System Diseases [C20]
Gender: Female, Male. Age: 0-17 years, 18-64 years, 65+ years. Enrolment: 577.
Start date (EU): 2026-03-23. Decision date: 2026-02-24. Results received: No. Last updated: 2026-07-16.
Decision dates by country: AT: 2026-03-01, BE: 2026-02-24, BG: 2026-02-27, HU: 2026-02-25, LT: 2026-02-24, PL: 2026-02-26, NO: 2026-03-11, ES: 2026-02-27, GR: 2026-02-25, SK: 2026-02-24, CZ: 2026-02-24, IT: 2026-02-25, FR: 2026-02-24, NL: 2026-02-26, DE: 2026-02-25

Condition(s): Immune system disseases
Product: Matched placebo for test product, Duvakitug

Primary endpoint: Sub-Study 2: Co-primary endpoints US/FDA: Proportion of participants achieving clinical remission per Crohn’s Disease Activity Index (CDAI) at Week 12, Sub-Study 2: Co-primary endpoints US/FDA: Proportion of participants achieving endoscopic response (Simple Endoscopic Score for Crohn's Disease [SES-CD]) at Week 12, Sub-Study 2: Co-primary endpoints EU/EMA: Proportion of participants achieving clinical remission per 2-item patient-reported outcome (PRO-2) at Week 12, Sub-Study 2: Co-primary endpoints EU/EMA: Proportion of participants achieving endoscopic response (SES-CD) at Week 12
Endpoint(s): Sub-Study 2: Proportion of participants achieving CDAI clinical response at Week 12, Sub-study 2: Proportion of participants achieving CDAI clinical response and endoscopic response (SES-CD) at Week 12, Sub-study 2: Proportion of participants achieving endoscopic SES- CD remission at Week 12, Sub-study 2: US/FDA: Proportion of participants achieving clinical remission per PRO-2 at Week 12, Sub-study 2: EU/EMA: Proportion of participants achieving clinical remission per CDAI at Week 12, Sub-study 2: Proportion of participants achieving ulcer-free endoscopy (in the subset of participants with ulcers at baseline) at Week 12, Sub-study 2: Change from baseline in Patient-Reported Outcomes Measurement Information System (PROMIS)-Fatigue Short Form 7a T-score at Week 12, Sub-study 2: Proportion of participants achieving CDAI clinical response at Week 4, Sub-study 2: US/FDA: Proportion of participants achieving corticosteroid free remission (in the subset of participants with corticosteroids at baseline) per CDAI at Week 12, Sub-study 2: EU/EMA: Proportion of participants achieving corticosteroid free remission per PRO-2 (in the subset of participants with corticosteroids at baseline) at Week 12, Sub-study 2: Proportion of participants achieving CDAI clinical remission and endoscopic remission (SES-CD) at Week 12, Sub-study 2: Change from baseline in Inflammatory Bowel Disease Questionnaire (IBDQ) total score at Week 12, Sub-study 2: Proportion of participants with no bowel urgency by Numeric Rating Scale (NRS) at Week 12, Sub-study 2: Proportion of participants with CD-related hospitalizations by Week 12, Sub-study 2: Number of participants with any Treatment Emergent Adverse Events (TEAEs), treatment-emergent adverse event of special interest (TEAESIs), treatment-emergent serious adverse event (TESAEs), and TEAEs leading to permanent study intervention discontinuation, Sub-study 2: Serum concentrations of duvakitug, Sub-study 2: Incidence of treatment-emergent Anti-drug Antibodies (ADA) against duvakitug

Source: https://euclinicaltrials.eu/ctis-public/view/2025-521036-11-00